EU clinical trial 2022-502891-22-00: A study of HFB200603 as a single agent and in combination with Tislelizumab in patients with advanced solid tumors
Protocol code: HFB-200603-01
Sponsor: Hifibio Inc. (Pharmaceutical company). Phase: Human Pharmacology (Phase I)- First administration to humans. Countries: Italy (ended), Spain (ended).
Therapeutic area(s): Diseases [C] - Neoplasms [C04]
Gender: Female, Male. Age: 18-64 years, 65+ years. Enrolment: 96.
Status: Ended. Start date (EU): 2023-08-02. End date (EU): 2026-03-09. End date: 2026-03-10. Decision date: 2023-07-03. Results received: No. Last updated: 2025-09-09.
Decision dates by country: IT: 2023-07-03, ES: 2023-07-04

Condition(s): Advanced Solid Tumors

Source: https://euclinicaltrials.eu/ctis-public/view/2022-502891-22-00